EU clinical trial 2023-510463-35-00: ETOP 22-22 ADEPPT: A multicentre, single-arm phase II trial of adagrasib in patients with KRASG12C-mutant NSCLC, including the elderly (≥70 years) or patients with poor performance status
Protocol code: ETOP 22-22 ADEPPT
Sponsor: ETOP IBCSG Partners Foundation (Laboratory/Research/Testing facility). Phase: Therapeutic exploratory (Phase II). Countries: Spain (ongoing, recruitment ended), France (ended), Ireland (ended), Belgium (ended), Italy (ongoing, recruitment ended).
Therapeutic area(s): Diseases [C] - Respiratory Tract Diseases [C08]; Diseases [C] - Neoplasms [C04]
Gender: Female, Male. Age: 18-64 years, 65+ years. Enrolment: 53.
Start date (EU): 2023-04-26. Decision date: 2024-03-13. Results received: No. Last updated: 2026-04-21.
Decision dates by country: BE: 2024-03-28, ES: 2024-03-13, FR: 2024-03-14, IT: 2024-03-22, IE: 2024-03-13

Condition(s): Patients with KRASG12C-mutant NSCLC, including patients aged ≥18 years with poor performance status (ECOG PS=2) Cohort 1 or elderly (≥70 years) (ECOG PS=0-1) Cohort 2
Product: Adagrasib

Primary endpoint: Objective Response Rate (ORR) per RECIST v1.1, assessed at 12 weeks.
Endpoint(s): - Durable clinical benefit (DCB) - Time to progression (TTP) - Progression-free Survival (PFS) - Overall Survival (OS) - Safety - Patient-related outcomes

Source: https://euclinicaltrials.eu/ctis-public/view/2023-510463-35-00